EU clinical trial 2024-517663-23-01: A Phase 2, Open-label, Multiple Ascending-Dose Study to Evaluate the Safety, Tolerability and Efficacy of ARCT-032 in People with Cystic Fibrosis
Protocol code: ARCT-032-02
Sponsor: Arcturus Therapeutics Europe B.V. (Pharmaceutical company). Phase: Therapeutic exploratory (Phase II). Countries: Poland (ended), Greece (ended).
Therapeutic area(s): Diseases [C] - Respiratory Tract Diseases [C08]
Gender: Female, Male. Age: 18-64 years, 65+ years. Enrolment: 10.
Status: Ended. End date (EU): 2026-02-03. Decision date: 2025-07-31. Results received: No. Last updated: 2025-11-18.
Decision dates by country: PL: 2025-08-04, GR: 2025-07-31

Condition(s): Cystic Fibrosis

Primary endpoint: AEs, adverse events of special interest (AESIs), and serious adverse events (SAEs) (incidence, severity, dose relationship)., Changes from baseline in vital signs and physical examinations., Changes from baseline in laboratory test results., Evaluation for bronchospasm (changes from pre-dose to post-dose FEV1).
Endpoint(s): Plasma pharmacokinetics of ARCT-032 based on the observed concentrations of mRNA-[CCI] in plasma after single and multiple doses of ARCT-032., Mean absolute change from baseline in pre-dose percent predicted FEV1 on Day [CCI] of the treatment period., Change from baseline in Cystic Fibrosis Questionnaire – Revised Respiratory Symptoms Scale (CFQ-R RSS) score on Day [CCI].

Source: https://euclinicaltrials.eu/ctis-public/view/2024-517663-23-01